EU clinical trial 2025-520518-79-00: A randomized, placebo-controlled, participant- and investigator-blinded study to evaluate the efficacy in reducing atrial fibrillation burden (AFB) as well as the safety, tolerability, and pharmacokinetics of oral PKN605 in participants with atrial fibrillation
Protocol code: CPKN605A12201
Sponsor: Novartis Pharma AG (Pharmaceutical company). Phase: Therapeutic exploratory (Phase II). Countries: Netherlands (ongoing, recruiting), Germany (ongoing, recruiting).
Therapeutic area(s): Diseases [C] - Cardiovascular Diseases [C14]
Gender: Female, Male. Age: 18-64 years, 65+ years. Enrolment: 41.
Status: Ongoing, recruiting. Start date (EU): 2026-01-06. Decision date: 2025-11-17. Results received: No. Last updated: 2026-06-24.
Decision dates by country: DE: 2025-11-19, NL: 2025-11-17

Condition(s): Atrial Fibrillation
Product: Placebo to PKN605 50 mg film-coated tablets, PKN605

Primary endpoint: AFB from ECG patch monitors, defined as the amount of time spent in AF as a proportion of the analyzable monitoring time
Endpoint(s): Time (d) from the date of randomization to first AF recurrence and presence (or absence) of AF recurrence after randomization detected by ECG patch monitor, 12-lead ECG, handheld ECG, or other protocol-approved method for ascertainment, Adverse events, vital signs, 12-lead ECG parameters (including QTcF), and laboratory assessments, PKN605 plasma concentrations; Ctrough (pre-dose), C2h, C4h

Source: https://euclinicaltrials.eu/ctis-public/view/2025-520518-79-00